EU clinical trial 2024-511635-94-00: An Open Label, Phase 2 Study to Evaluate Activity and Safety of Daratumumab in combination with Bortezomib and Dexamethasone in patients with Relapsed or Refractory Plasmablastic lymphoma (DALYA trial)
Sponsor: Fondazione Italiana Linfomi Ets (Patient organisation/association). Phase: Therapeutic exploratory (Phase II). Countries: Italy (ongoing, recruiting).
Therapeutic area(s): Diseases [C] - Hemic and Lymphatic Diseases [C15]
Gender: Female, Male. Age: 18-64 years, 65+ years. Enrolment: 28.
Status: Ongoing, recruiting. Start date (EU): 2022-07-11. Decision date: 2025-01-08. Results received: No. Last updated: 2026-06-18.

Condition(s): Relapsed or Refractory Plasmablastic lymphoma
Product: DARATUMUMAB, BORTEZOMIB, DEXAMETHASONE

Primary endpoint: Overall Response Rate (ORR = Complete response, CR+ Partial response, PR) after induction cycle 1 (daratumumab alone), after induction cycles 3, 6 and 9 (end of induction, EOI); after maintenance cycles 12 and 15 (end of treatment, EOT). Response will be defined according to the Lugano 2014 criteria. The best response achieved per patient will be considered for analysis.
Endpoint(s): Progression-free survival (PFS), defined as the time from treatment start and progression/relapse or death from any cause (Lugano 2014), Overall survival (OS), defined as the time from treatment start and death from any cause (Lugano 2014)., Duration of response (DOR), defined for all patients who achieved a response (CR or PR) according to Response Criteria for NHL CT-based and/or PET-based (Lugano 2014), and is measured from the date when criteria for response are met (CR or PR) until the date of progression or relapse., Role of daratumumab maintenance in terms of conversion rate of SD to PR or from SD/PR to CR., Association between intensity of CD38 expression and response. The extent of CD38 expression evaluated by immunochemistry will be correlated with response measured according to the Lugano 2014 criteria at various timepoints., Endpoints of the biological study: Impact of daratumumab/bortezomib treatment in immune activation, T cell differentiation, MDSC by multiparametric flow cytometry., Endpoints of the biological study: Impact of daratumumab/bortezomib treatment on the level of pro- and anti-inflammatory cytokines by Luminex technology., Endpoints of the biological study: Analysis of tumor microenvironment by ICH/alternative methods.

Source: https://euclinicaltrials.eu/ctis-public/view/2024-511635-94-00